EU clinical trial 2025-524764-38-00: Study of diclofenac skin reservoir formation and emptying after Voltaren Emulgel 2.32% application in healthy participants
Protocol code: 400314
Sponsor: Haleon CH SARL (Pharmaceutical company). Phase: Human Pharmacology (Phase I)- Other. Countries: Germany (ended).
Therapeutic area(s): Analytical, Diagnostic and Therapeutic Techniques and Equipment [E] - Therapeutics [E02]
Gender: Female, Male. Age: 18-64 years, 65+ years. Enrolment: 12.
Status: Ended. Start date (EU): 2026-05-26. End date (EU): 2026-07-20. End date: 2026-07-21. Decision date: 2026-04-09. Results received: No. Last updated: 2026-04-09.

Condition(s): For the local, symptomatic treatment of pain in acute bruises, strains, or sprains due to blunt trauma, e.g., sports and accident injuries

Source: https://euclinicaltrials.eu/ctis-public/view/2025-524764-38-00